EU clinical trial 2023-505672-30-00: A Randomized, Open-Label, Multicenter, Phase II Study of Multiple Doses of RO7247669 in Participants with Previously Untreated Unresectable or Metastatic Melanoma
Protocol code: BP43963
Sponsor: F. Hoffmann-La Roche AG (Pharmaceutical company). Phase: Therapeutic exploratory (Phase II). Countries: Poland (ended), Greece (ended), Slovakia (ended), Czechia (ended), Spain (ended).
Therapeutic area(s): Diseases [C] - Neoplasms [C04]
Gender: Female, Male. Age: 18-64 years, 65+ years. Enrolment: 37.
Status: Ended. Start date (EU): 2023-02-10. End date (EU): 2025-09-30. End date: 2025-11-27. Decision date: 2024-01-29. Results received: No. Last updated: 2025-10-06.
Decision dates by country: CZ: 2024-01-30, ES: 2024-01-29, GR: 2024-03-14, PL: 2024-02-19, SK: 2024-01-29

Condition(s): Unresectable or Metastatic Melanoma
Product: RO7247669

Primary endpoint: 1. PFS defined as the time from randomization to the first occurrence of progression as determined by the Investigator according to RECIST v1.1 or death during the treatment period or within 60 days of the last tumor assessment after treatment discontinuation from any cause, whichever occurs first
Endpoint(s): 1. Nature, frequency, and severity of AEs graded according to the NCI CTCAE v5.0, 2. ORR, defined as the proportion of participants with an objective response (i.e., complete response [CR] or partial response [PR]), according to RECIST v1.1, 3. DCR, defined as ORR + stable disease rate (SDR), 4. DoR for participants with objective response, defined as the time from the first occurrence of a documented objective response to disease progression according to RECIST v1.1 or death from any cause, whichever occurs first, 5. Serum concentrations, PK profiles and parameters for RO7247669, 6. Incidence and titer of RO7247669 ADAs during the study relative to the prevalence of ADA at baseline, 7. Relationship between ADA status and PK, safety, pharmacodynamics, and efficacy, 8. Changes from baseline in the phenotype and activation status of T cell subsets in the peripheral blood (CD4/CD8 HLA-DR+/Ki67+), 9. changes from baseline in the tumor microenvironment (such as CD8 T-cell infiltration, proliferation (CD8+Ki67+))

Source: https://euclinicaltrials.eu/ctis-public/view/2023-505672-30-00